EU clinical trial 2024-515561-34-01: Safety and Efficacy of Intravenous Thrombolysis in Patients with Ischemic Stroke on Treatment with Direct Oral Anticoagulants: DO-IT – The DOAC Intravenous Thrombolysis trial
Protocol code: DO-IT
Sponsor: Insel Gruppe AG (Hospital/Clinic/Other health care facility). Phase: Therapeutic use (Phase IV). Countries: Netherlands (ongoing, recruiting), Spain (ongoing, recruiting), Germany (ongoing, recruiting), Belgium (ongoing, recruiting), Austria (ongoing, recruiting), Finland (ongoing, recruiting), France (ongoing, recruiting), Portugal (ongoing, recruiting), Norway (authorised, recruiting).
Therapeutic area(s): Not possible to specify
Gender: Female, Male. Age: 18-64 years, 65+ years. Enrolment: 455.
Start date (EU): 2025-08-04. Decision date: 2025-07-01. Results received: No. Last updated: 2026-07-17.
Decision dates by country: ES: 2025-07-04, NL: 2025-07-07, DE: 2025-07-02, NO: 2026-02-02, FR: 2026-01-16, FI: 2026-01-21, AT: 2026-01-30, PT: 2025-11-24, BE: 2025-07-01

Condition(s): Acute ischemic stroke with recent ingestion of direct oral anticoagulants.
Product: Metalyse 10 000 units (50 mg) powder and solvent for solution for injection, Actilyse® Pulver und Lösungsmittel zur Herstellung einer Injektions- bzw. Infusionslösung

Primary endpoint: modified Rankin Scale (mRS, functional outcome) at 90 days ± 2 weeks (shift analysis)
Endpoint(s): Dichotomized good functional outcome (mRS 0-2 or return to baseline at day 90 (±2 weeks)), change in stroke severity (National Institutes of Health Stroke Scale and ischemic stroke volume) between baseline and 24 ± 12 hours, health-related Quality of Life (EuroQol 5D-3L) at 90 days ± 2 weeks, symptomatic intracranial hemorrhage within the first 36 hours (European Co-operative Acute Stroke Study-II definition), major extracranial bleeding up to 24 + 12 hours, all-cause mortality up to 7 days after admission or until discharge

Source: https://euclinicaltrials.eu/ctis-public/view/2024-515561-34-01